EU clinical trial 2023-507788-20-00: A phase 1, open-label, cross-over study in healthy volunteers to assess the pharmacokinetic profile of Prazosin and Cyproheptadine following single dose oral administration of KT110 tablet and following administration of Alpress and Periactine marketed tablets
Protocol code: OP111821.KIN
Sponsor: Kinnov Therapeutics (SME). Phase: Human Pharmacology (Phase I)- First administration to humans. Countries: France (ended).
Therapeutic area(s): Diseases [C] - Nervous System Diseases [C10]
Gender: Female, Male. Age: 18-64 years. Enrolment: 8.
Status: Ended. Start date (EU): 2024-04-11. End date (EU): 2024-07-29. Decision date: 2024-03-22. Results received: No. Last updated: 2024-03-26.

Condition(s): alcohol use disorder

Source: https://euclinicaltrials.eu/ctis-public/view/2023-507788-20-00